EU clinical trial 2024-511306-23-00: Add-Aspirin: A phase III, double-blind, placebo controlled, randomised trial assessing the effects of aspirin on disease recurrence and survival after primary therapy in common non metastatic solid tumours.
Protocol code: AA01
Sponsor: University College London (Educational Institution). Phase: Therapeutic confirmatory (Phase III). Countries: Ireland (ongoing, recruitment ended).
Therapeutic area(s): Diseases [C] - Neoplasms [C04]
Gender: Female, Male. Age: 18-64 years, 65+ years. Enrolment: 204.
Status: Ongoing, recruitment ended. Start date (EU): 2024-07-01. Decision date: 2024-07-01. Results received: No. Last updated: 2025-06-24.

Condition(s): Breast cancer, colon cancer, rectal cancer, stomach cancer, oesophageal cancer, prostate cancer
Product: Matching placebo for Aspirin protect 100mg. Pharmaceutical form: Film-coated tablet. Route of administration: Oral use. Major ingredients: Lactose monohydrate 66mg, Cellulose microcrystalline 24mg, Calcium hydrogen phosphate dihydrate 12mg, Maize starch 12mg, Methacrylic acidethylacrylate copolymer 8.1mg, Talc 8.1mg., Aspirin® protect 100 mg Magensaftresistente Tablette Acetylsalicylsäure, Matching placebo for aspirin protect 300mg. pharmaceutical form: film-coated tablet. route of administration: oral use. major ingredients: Lactose monohydrate 198mg, Cellulose microcrystalline 72mg, Calcium hydrogen phosphate dihydrate 36mg, Maize starch 36mg, Methacrylic acidethylacrylate copolymer 22.38mg, Talc 22.38mg., Aspirin® protect 300 mg Magensaftresistente Tablette Acetylsalicylsäure

Primary endpoint: All participants: Overall survival, Breast cancer participants: Invasive disease-free survival, Colorectal cancer: Disease-free survival, Gastro-oesophageal cancer: Disease-free survival, Prostate cancer: Biochemical recurrence-free survival
Endpoint(s): Overall survival, Adherence, Toxicity, Serious haemorrhage, Serious vascular events, Thrombotic events, Diabetes and associated complications, Second malignancies, Age-related macular degeneration, Cognitive assessment, Dementia, Functional capacity, Exercise levels, Breast cancer-specific survival, Bone metastases-free survival (breast cancer), IDFS-DCIS (invasive disease-free survival ductal carcinoma in-situ) (breast cancer), Colorectal cancer-specific survival, Prostate cancer-specific survival, Time to initiation of salvage treatment (prostate cancer), Bone metastases-free survival (prostate cancer)

Source: https://euclinicaltrials.eu/ctis-public/view/2024-511306-23-00